EU clinical trial 2022-502808-72-00: HOVON 158 CLL: First line treatment with VeNEtoclaX and ibruTinib induction followed by obinutuzumab intenSificaTion Exclusively in CLL/SLL Patients not in complete remission and/or with detectable bone marrow minimal residual disease (NEXT STEP trial)
Protocol code: HO158
Sponsor: Hemato-Oncologie voor Volwassenen Nederland (Hovon) Stichting (Hospital/Clinic/Other health care facility). Phase: Therapeutic exploratory (Phase II). Countries: Netherlands (ongoing, recruitment ended), Denmark (ongoing, recruitment ended).
Therapeutic area(s): Diseases [C] - Neoplasms [C04]; Diseases [C] - Hemic and Lymphatic Diseases [C15]
Gender: Female, Male. Age: 18-64 years, 65+ years. Enrolment: 85.
Status: Ongoing, recruitment ended. Start date (EU): 2024-09-11. Decision date: 2024-09-11. Results received: No. Last updated: 2026-05-29.
Decision dates by country: DK: 2024-09-13, NL: 2024-09-11

Condition(s): Chronic Lymphocytic Leukemia
Product: IMBRUVICA 140 mg film-coated tablets, Venclyxto 50 mg film-coated tablets, Gazyvaro 1,000 mg concentrate for solution for infusion., Venclyxto 100 mg film-coated tablets, Venclyxto 10 mg film-coated tablets

Primary endpoint: BM uMRD CR 3 months after end of intensification with ibrutinib/obinutuzumab in patients who were not in CR or who had detectable MRD on combination ibrutinib and venetoclax.
Endpoint(s): BM uMRD CR 9 months after registration 2 in all subjects, Best BM MRD level during on protocol, MRD level in BM and PB at different time points on protocol and in follow up, Best response by IWCLL on protocol, Response by IWCLL at different time points, Response by Deauville criteria on PET scan at different time points, Progression free survival (PFS), defined as time from registration 1 and from registration 2 to progression or death from any cause, whichever comes first, Event free survival (EFS), defined as time from registration 1 and from registration 2 to start new CLL treatment, progression or death, whichever comes first, Overall survival (OS), defined as time from registration 1 and from registration 2 to death from any cause, Treatment free interval (TFI), defined as date of last protocol treatment to start date of first CLL treatment off protocol, or death from any cause whichever comes first, Predictive value of prognostic markers at diagnosis on uMRD and ORR by IWCLL and Deauville criteria at end of ibrutinib/venetoclax and ibrutinib/obinutuzumab;, CTCAE grade ≥2 toxicities, IWCLL hematological grade ≥ 2 toxicities, Exploratory: MRD level in BM and PB at different time points on protocol and in follow up by novel techniques, Exploratory: Quantification of lesions on 18F-FDG PET-CT at different time points, Exploratory: Amount of CLL cells in LN biopsy and FNA, Exploratory: Immune cell subsets and function at different time points, Exploratory: QoL at different time points on protocol and in follow up

Source: https://euclinicaltrials.eu/ctis-public/view/2022-502808-72-00